EU clinical trial 2025-521736-10-00: Clinical trial to evaluate the efficacy and safety of Depigoid Grass-Mix at 1000 DPP/mL and Depigoid FORTE Grass-Mix at 3000 DPP/mL compared with placebo in patients suffering from allergic rhinoconjunctivitis with or without controlled asthma due to clinically relevant sensitisation to grass pollen.
Protocol code: 0600-PG-PSC-218
Sponsor: LETI Pharma S.L.U. (Pharmaceutical company). Phase: Therapeutic confirmatory (Phase III). Countries: Portugal (authorised, recruiting), Spain (ongoing, recruiting).
Therapeutic area(s): Diseases [C] - Immune System Diseases [C20]; Diseases [C] - Respiratory Tract Diseases [C08]
Gender: Female, Male. Age: 0-17 years, 18-64 years, 65+ years. Enrolment: 324.
Start date (EU): 2026-06-23. Decision date: 2026-03-25. Results received: No. Last updated: 2026-07-03.
Decision dates by country: PT: 2026-03-25, ES: 2026-03-25

Condition(s): Allergic rhinoconjunctivitis with or without controlled asthma
Product: The placebo to be used in the clinical trial is the solvent used in the investigational medicinal products’ (IMPs) formulation. The resulting product is a suspension., Depigoid Grass-Mix (1000 DPP/ml), Depigoid FORTE Grass-Mix (3000 DPP/ml), Conjunctival Provocation Test Grass-Mix LETI 30 HEP/ml

Primary endpoint: Double-Blind, Randomised, Controlled Phase: Mean cSMS (0-6) at peak grass pollen season comparing active and placebo groups after at least 8 injections of treatment. o Medication score: 0 no medication, 0.5 antihistamine eye drops, 1 oral antihistamine, 1.5 intranasal corticoid o Symptom score:Please refer to the protocol for further details
Endpoint(s): Double-Blind, Randomised, Controlled Phase: Absolute values and changes from baseline (if applicable) during active pollen season comparing active and placebo groups after at least 8 injections: - Mean cSMS during the whole grass pollen season-Asthma symptoms and asthma medication score. Please refer to the Protocol for further details.Open-label Phase:Please refer to the Protocol for further details

Source: https://euclinicaltrials.eu/ctis-public/view/2025-521736-10-00